EU clinical trial 2024-516103-16-00: GRAALL2014
Sponsor: Assistance Publique Hopitaux De Paris (Hospital/Clinic/Other health care facility). Phase: Therapeutic exploratory (Phase II). Countries: France (ongoing, recruiting), Belgium (authorised, recruitment pending).
Therapeutic area(s): Diseases [C] - Immune System Diseases [C20]
Gender: Female, Male. Age: 18-64 years, 65+ years. Enrolment: 1506.
Start date (EU): 2015-12-04. Decision date: 2024-11-14. Results received: No. Last updated: 2025-01-17.
Decision dates by country: FR: 2024-11-14, BE: 2025-01-17

Condition(s): Acute Lymphoblastic Leukemia (ALL) in younger adults (18-59 years)

Source: https://euclinicaltrials.eu/ctis-public/view/2024-516103-16-00